EU clinical trial 2026-525208-90-00: A Phase 1, drug-drug interaction trial of IMU-838 with oral contraceptives in women
Protocol code: P1-IMU-838-DDI-COC
Sponsor: Immunic AG (Pharmaceutical company). Phase: Human Pharmacology (Phase I)- Other. Countries: Belgium (ongoing, recruiting).
Therapeutic area(s): Diseases [C] - Nervous System Diseases [C10]
Gender: Female. Age: 18-64 years. Enrolment: 26.
Status: Ongoing, recruiting. Start date (EU): 2026-04-01. Decision date: 2026-03-16. Results received: No. Last updated: 2026-06-25.

Condition(s): Multiple sclerosis

Source: https://euclinicaltrials.eu/ctis-public/view/2026-525208-90-00